EU clinical trial 2026-525974-21-00: A Phase 2b, multicenter, randomized, double-blind, placebo-controlled, parallel-group, dose-finding study of YMI024 to assess efficacy in reducing inflammatory markers, safety, and tolerability in adults with stable coronary artery disease and elevated hsCRP
Protocol code: CYMI024A12202
Sponsor: Novartis Pharma AG (Pharmaceutical company). Phase: Therapeutic exploratory (Phase II). Countries: Germany (authorised, recruitment pending).
Therapeutic area(s): Diseases [C] - Cardiovascular Diseases [C14]
Gender: Female, Male. Age: 18-64 years, 65+ years. Enrolment: 43.
Status: Authorised, recruitment pending. Decision date: 2026-08-05. Results received: No. Last updated: 2026-08-05.

Condition(s): Chronic Kidney Disease, Heart Failure, Coronary Artery disease

Primary endpoint: Change from baseline in log-transformed IL-6
Endpoint(s): Change from baseline in log-transformed IL-6, Change from baseline in log-transformed hsCRP, Responder status (yes/no), defined as hsCRP <2 mg/L, Responder status (yes/no), defined as hsCRP <1 mg/L, Adverse events, and parameters from safety assessments, including vital signs, ECGs, and laboratory assessments (urine and blood) through the end of treatment / study (EOT/EOS)

Source: https://euclinicaltrials.eu/ctis-public/view/2026-525974-21-00